EU clinical trial 2022-501130-33-00: CITAR - Comparison of the efficacy and safety of early use of IL-6R blockade with tocilizumab in combination with short-term glucocorticoids versus glucocorticoids alone for the treatment of arthritis induced by cancer immunotherapy by check point inhibitors: a randomized, open, multicentre, proof of concept, superiority, controlled clinical trial
Sponsor: Karolinska University Hospital (Hospital/Clinic/Other health care facility). Phase: Therapeutic exploratory (Phase II). Countries: Sweden (ongoing, recruiting), France (ongoing, recruiting).
Therapeutic area(s): Phenomena and Processes [G] - Immune System Phenomena [G13]; Diseases [C] - Musculoskeletal Diseases [C05]
Gender: Female, Male. Age: 18-64 years, 65+ years. Enrolment: 57.
Status: Ongoing, recruiting. Start date (EU): 2023-10-11. Decision date: 2023-03-07. Results received: No. Last updated: 2026-03-04.
Decision dates by country: FR: 2025-04-11, SE: 2023-03-07

Condition(s): Patients with histologically (or via cytology) confirmed cancer that develop arthritis secondary to treatment with immune checkpoint inhibitors.
Product: RoActemra 162 mg solution for injection in pre-filled pen., Prednisolon Pfizer 5 mg tabletter, Prednisolon Pfizer 2,5 mg tabletter

Primary endpoint: % of patients in arm A and arm B with Clinical Disease Activity Index (CDAI): CDAI ≤10 at week 16
Endpoint(s): 1. % of patients in arm A and arm B with Clinical Disease Activity Index (CDAI): CDAI ≤10 at week 24, 2. % of patients in arm A and arm B with CDAI ≤2.8 at week 16 and 24, 3. % of patients in arm A and arm B with CDAI ≤10 AND Prednisolone 0-5mg/d at week 16 and 24, 4. % of patients in arm A and arm B with CDAI ≤10 AND Prednisolone 0 mg/d at week 16 and 24, 5. Improvement in pain (VAS 0-100mm), general health (VAS 0-100mm), fatigue (VAS 0-100mm), functional status (HAQ questionnaire) and quality of life (EQ5D questionnaire) in arm A and B, at week 16 and 24, 6. Progression-free survival and overall survival of patients in arm A and arm B at week 16 and 24, 7. Total number of missed treatment cycles with ICI, at week 24, 8. % of patients with AEs and SAEs in arm A and B from baseline to week 24

Source: https://euclinicaltrials.eu/ctis-public/view/2022-501130-33-00